EU clinical trial 2024-513600-33-00: Impact of the presence of the corpus luteum on pregnancies obtained through frozen embryo transfer(FET): a prospective randomizedcontrolled study
Protocol code: LUTI Study
Sponsor: Fundacio De Recerca Clinic Barcelona-Institut D’Investigacions Biomediques August Pi I Sunyer (Laboratory/Research/Testing facility). Phase: Therapeutic use (Phase IV). Countries: Spain (ongoing, recruiting).
Therapeutic area(s): Analytical, Diagnostic and Therapeutic Techniques and Equipment [E] - Investigative Techniques [E05]; Diseases [C] - Female Urogenital Diseases and Pregnancy Complications [C13]; Phenomena and Processes [G] - Chemical Phenomena [G02]
Gender: Female. Age: 18-64 years. Enrolment: 240.
Status: Ongoing, recruiting. Start date (EU): 2024-12-10. Decision date: 2024-10-23. Results received: No. Last updated: 2024-10-23.

Condition(s): Infertility
Product: CHORIOGONADOTROPIN ALFA, ESTRADIOL, PROGESTERONE

Primary endpoint: Maternal: Relaxin-2 plasma concentrations., -Fetal: Mitral annular plane systolic excursión (MAPSE) assessed by echocardiography.
Endpoint(s): Angiogenic/vasoactive function of CL and placenta: plasma concentrations of VEGF-A, sFlt-1, PlGF progesterone, beta-hCG. , Maternal endothelial function: plasma concentrations of VCAM-1 and endoglin., ICAM-1 and VCAM-1 on the endothelial cells (EC) surface, VE-Cadherin at the EC junctions, intracellular endothelial nitric oxide synthase in EC, von Willebrand Factor in the extracellular matrix (ECM), thrombomodulin in ECM, tissue factor in ECM, Intracellular activation of ERK1/2, p38MAPK, SAPK/JNL and AKT. Fluorescent microspheres (permeability assay). EC proliferation-tube formation (angiogenesis assay)., Maternal cardiovascular function: Plasma NT-proBNP concentration., Systolic, diastolic and mean arterial blood pressure (mmHg)., Carotid artery intima-media thickness (mm)., Maternal echocardiography: cardiac output (L/min), left ventricular remodeling parameters and total vascular resistance (dyn/sec/cm5)., Fetal programming: Cardiac: sphericity index, longitudinal and transverse heart diameter (mm)., Transverse and longitudinal diameters and sphericity index of atria and ventricles. Tricuspid annular plane systolic excursion (TAPSE)(mm). Tricuspid annulus tissue Doppler [E', A' and S' wave (cms/s)]. Isovolumetric relaxation time (IRT), Cerebral cortex development: Depth of parietooccipital, cingulate and calcarine sulci (mm) corrected by DBP x 100. , Fetal growth. First trimester: fetal crown-rump length (CRL), nuchal translucency (NT), ductus venosus pulsatility index (DV-PI), mean uterine artery pulsatility index (mUt-PI)., Fetal growth ultrasound (second and third trimester): 1) Biometry (mm): biparietal diameter (BPD), head circumference (HC), abdominal circumference (AC) and femoral length (FL)., 2) Estimated fetal weight (g) and centile., 3) Doppler study of umbilical artery (UA), middle cerebral artery (MCA) and mUt-PI., 4) Study of Fetal Limb Volume (FLV) by 3D-echo (ml). , Neonatal data: Apgar 5', umbilical artery pH, gender, birth weight and centile based on our population normality, Placental study: Pregnancy: location of placenta (anterior, posterior, lateral or previa) and signs of placenta accreta spectrum disorders. Anatomopathologycal study of the placenta: weight (fresh, gr.) and histopathology, Preconceptional parameters: Both parents: age, ethnicity, socioeconomic status, education level, BMI, chronic diseases, smoking, alcohol consumption, illicit substance abuse., Infertility and IVF data: number of previous pregnancies, previous obstetric complications, smoking during pregnancy, alcohol or illicit drugs consumption during pregnancy, infertility etiology, infertility length, number of previous unsuccessful embryo transfers, Ovarian stimulation protocol, gonadotrophin dose, ovarian stimulation duration, estradiol at trigger day, number of follicles at trigger, number of oocytes, number of MII, fertilization technique, Number of embryos, number of blastocysts, period of vitrification, transferred blastocyst quality. Lifestyle questionaries: PREDIMED, IPAQ, WHO-5, PSS-14, PSQI, , HDRS, FertiQol.

Source: https://euclinicaltrials.eu/ctis-public/view/2024-513600-33-00